EU clinical trial 2025-522730-31-00: Standardized Phleum pratense in TBU/ml in liquid formulation for sublingual immunotherapy: Phase II, randomized dose determination clinical trial. DEDO-G Study.
Protocol code: APISLIT-DD-G-2025-01
Sponsor: Asac Pharmaceutical Inmunology S.A. (Pharmaceutical company). Phase: Therapeutic exploratory (Phase II). Countries: Spain (authorised, recruitment pending).
Therapeutic area(s): Diseases [C] - Immune System Diseases [C20]
Gender: Female, Male. Age: 0-17 years, 18-64 years. Enrolment: 120.
Status: Authorised, recruitment pending. Decision date: 2026-04-14. Results received: No. Last updated: 2026-08-05.

Condition(s): Allergic rhinitis/rhinoconjunctivitis caused by grass polen allergy
Product: Placebo, Vacuna Phleum pratense 3000 TBU/ml, Vacuna Phleum pratense 6000 TBU/ml, Test de provocación nasal Phleum pratense, Vacuna Phleum pratense 1000 TBU/ml

Primary endpoint: The individual response of each recruited subject to the Nasal Provocation Test (NPT). NPT response will be assessed using objective and subjective parameters. Objective assessment will be based on changes in Nasal Inspiratory Peak Flow (NIPF), while subjective assessment will be based on the Total Nasal Symptom Score (TNSS, 0–12). NPT positivity will be determined according to protocol-defined criteria.
Endpoint(s): Determination of systemic and/or local adverse reactions associated with the trial, particularly those related to investigational product/placebo, and those due to the nasal provocation test or skin prick test., Rescue medication used throughout the study in relation to the investigational product/placebo (this does not include any rescue medication that may be administered after the nasal provocation test or skin prick test)., Laboratory determinations of serum markers at baseline and end of study: Specific IgE to Phleum pratense and major allergens rPhl p1 + rPhl p5b., y Phleum pratense IgG4., Phleum pratense skin prick test at baseline and end of study for comparative analysis, Independent analysis of each of the clinical variables included in the nasal provocation test scoring scale

Source: https://euclinicaltrials.eu/ctis-public/view/2025-522730-31-00